EU clinical trial 2024-518759-45-00: SABINE - The efficacy and Safety of delayed-release Budesonide in children with primary IgA nephropathy - a multicenter, interventional phase III, randomized, placebo-controlled, double-blind study.
Protocol code: SABINE/01/2022
Sponsor: Medical University Of Warsaw (Educational Institution). Phase: Therapeutic confirmatory (Phase III). Countries: Poland (ongoing, recruiting).
Therapeutic area(s): Not possible to specify
Gender: Female, Male. Age: 0-17 years. Enrolment: 120.
Status: Ongoing, recruiting. Start date (EU): 2025-10-07. Decision date: 2025-06-27. Results received: No. Last updated: 2026-03-13.

Condition(s): Children primary nephropathy IgA
Product: Encorton, 1 mg, tabletki, Entocort, 3 mg, kapsułki o przedłużonym uwalnianiu, twarde, Placebo Prednisone/Budesonide, Encorton, 5 mg, tabletki

Primary endpoint: Reduction of UPCR after 24 weeks of treatment, Assessment of the percentage change in proteinuria at the end of treatment compared to the beginning of treatment
Endpoint(s): Number of side effects., Reduction in GFR during treatment, Reduction of UPCR after 24 weeks of treatment in relation to the beginning of treatment (deltaUPCR)

Source: https://euclinicaltrials.eu/ctis-public/view/2024-518759-45-00